EU clinical trial 2024-520388-15-00: A randomised non-inferiority trial with nested PK to assess DTG/3TC fixed dose formulations for the maintenance of virological suppression in children with HIV infection aged 2 to <15 years old
Protocol code: D3 (Penta 21)
Sponsor: Fondazione Penta Ets (Patient organisation/association). Phase: Therapeutic confirmatory (Phase III). Countries: Spain (ongoing, recruitment ended).
Therapeutic area(s): Diseases [C] - Virus Diseases [C02]
Gender: Female, Male. Age: 0-17 years. Enrolment: 6.
Status: Ongoing, recruitment ended. Start date (EU): 2023-06-30. Decision date: 2025-01-15. Results received: No. Last updated: 2026-03-24.

Condition(s): HIV-infected
Product: Dovato 50 mg/300 mg film-coated tablets, Truvada 200 mg/245 mg film-coated tablets, Descovy 200 mg/25 mg film-coated tablets, Combivir 150 mg/300 mg film-coated tablets, Epivir 300 mg film-coated tablets, Ziagen 300 mg film-coated tablets, Retrovir 250 mg capsules, hard, Kivexa 600 mg/300 mg film-coated tablets, Triumeq 50 mg/600 mg/300 mg film-coated tablets

Primary endpoint: Proportion of children with confirmed viral rebound (defined as the first of two consecutive HIV-1 RNA ≥50c/mL) by week 96.
Endpoint(s): Proportion of children with confirmed viral rebound (defined as the first of two consecutive HIV-1 RNA ≥50c/mL) by week 48., Proportion of children with confirmed HIV-1 RNA ≥50c/mL at weeks 48 and 96 (modified FDA snapshot), Proportion of children with HIV-1 RNA ≥50c/mL at weeks 24, 48 and 96 (including blips and confirmed measures ≥50c/mL), New resistance-associated mutations in those with confirmed HIV-1 RNA ≥50c/mL, Time to any new or recurrent WHO 3 or WHO 4 event or death, Change in CD4 (absolute and percentage) from baseline to weeks 24, 48 and 96, Incidence of serious adverse events, grade ≥3 clinical and laboratory adverse events, Incidence of adverse events leading to discontinuation or modification of the treatment regimen, Proportion of children with a change in ART for toxicity or switch to second-line, Change in blood lipids from baseline to weeks 48 and 96, Change in creatinine clearance estimated using bedside-Schwartz to weeks 48 and 96, Adherence as assessed by participant/care-giver questionnaires, Acceptability, sleep and mood, suicidality ideation and health-related quality of life as assessed by participant/care-giver completed questionnaires

Source: https://euclinicaltrials.eu/ctis-public/view/2024-520388-15-00